EU clinical trial 2024-517343-31-00: StAtins in Frail oldEr patients with ischemic Stroke or Transient ischemic attack – The Randomized Controlled Trial
Protocol code: NL86273.100.24
Sponsor: Amsterdam UMC Stichting (Hospital/Clinic/Other health care facility). Phase: Therapeutic use (Phase IV). Countries: Netherlands (ongoing, recruiting).
Therapeutic area(s): Diseases [C] - Nervous System Diseases [C10]
Gender: Female, Male. Age: 65+ years. Enrolment: 600.
Status: Ongoing, recruiting. Start date (EU): 2025-04-11. Decision date: 2024-12-10. Results received: No. Last updated: 2025-12-17.

Condition(s): Ischemic stroke and transient ischemic attack
Product: Pravastatine Viatris 10 mg Tabletten, Fluvastatine 20 mg PCH, capsules, Rosuvastatine Viatris 5 mg Filmtabletten, Simvastatine Mylan 40 mg, filmomhulde tabletten, Atorvastatine Viatris 10 mg Filmtabletten

Primary endpoint: • MACE-free survival over a two-year period, measured at 3, 6, 12, 18, and 24 months, with additional follow-up at three years for those enrolled early in the recruitment phase., • Health-Related Quality of Life (HRQoL) measured using the Patient-Reported Outcomes Measurement Information System - Global-10 (PROMIS-10) at 3, 6, 12, 18, and 24 months, with additional follow-up at three years for those enrolled early in the recruitment phase.
Endpoint(s): Number of new major cardiovascular events, Cognitive function at 12 and 24 months., Falls (number and time to first fall), Frailty status at 12 and 24 months., Functional outcome at 12 and 24 months.

Source: https://euclinicaltrials.eu/ctis-public/view/2024-517343-31-00